EU clinical trial 2025-524679-22-00: Up-titration of sulfonylurea (SU) in individuals with HNF1A- and HNF4A-MODY – A Steno MODERN-MODY project (MM-SUUP)
Sponsor: Steno Diabetes Center Copenhagen (Hospital/Clinic/Other health care facility). Phase: Therapeutic exploratory (Phase II). Countries: Denmark (ongoing, recruiting).
Therapeutic area(s): Diseases [C] - Hormonal diseases [C19]
Gender: Female, Male. Age: 18-64 years, 65+ years. Enrolment: 30.
Status: Ongoing, recruiting. Start date (EU): 2026-04-14. Decision date: 2026-03-04. Results received: No. Last updated: 2026-03-04.

Condition(s): Maturity-onset diabetes of the young type 3 (HNF1A-MODY), Maturity-onset diabetes of the young type 1 (HNF4A-MODY)
Product: GLIMEPIRIDE

Primary endpoint: Mean difference in time in tight range (3.9 – 7.8 mmol/l) measured by CGM in a two week-period at baseline and in the last two weeks of the intervention period
Endpoint(s): Mean difference in CGM-metric, mean glucose, measured at baseline and in the last two weeks of the intervention, Mean difference in CGM-metric, coefficient of variation (CV%), measured at baseline and in the last two weeks of the intervention, Mean difference in CGM-metric, standard deviation (SD), measured at baseline and in the last two weeks of the intervention, Mean difference in CGM-metric, percentage of time in range (3.9–10 mmol/l), measured at baseline and in the last two weeks of the intervention, Mean difference in CGM-metric, percentage of time above range (>10 mmol/l), measured at baseline and in the last two weeks of the intervention, Mean difference in haemoglobin A1c (HbA1c), Mean difference in total plasma glucose AUC obtained from the OGTT, Mean difference in total plasma C-peptide AUC obtained from the OGTT, Mean time to ceased SU titration, Mean tolerable dose of SU, Difference in proportion of individuals on any insulin treatment and stratified by insulin type (prandial/basal), Mean difference in daily dose of insulin (only for insulin-treated individuals at baseline), Mean difference in BMI, Mean difference in waist-to-height ratio, Mean difference in body fat mass, Rate ratio of hypoglycaemic events measured by CGM stratified by severity and study phase (up-titration and maintenance), Difference in proportion of participants with hypoglycaemic events measured by CGM stratified by severity (maintenance phase only), Mean difference in percentage of time <3.9 mmol/l, Mean difference in percentage of time <3.0 mmol/l, Rate ratio of participant-reported hypoglycaemic events stratified by severity and study phase, Difference in proportion of participants with participant-reported hypoglycaemic events stratified by severity (maintenance phase only)

Source: https://euclinicaltrials.eu/ctis-public/view/2025-524679-22-00